EU clinical trial 2024-511342-40-00: A Phase 1/2, Open-Label, Multicenter Trial with a Single Ascending Dose Cohort with Unilateral Intracochlear Injection Followed by a Bilateral Injection Expansion Cohort to Evaluate the Safety, Tolerability, and Efficacy of DB-OTO in Children and Infants with Biallelic hOTOF Mutations
Protocol code: DB-OTO-001
Sponsor: Regeneron Pharmaceuticals Inc. (Pharmaceutical company). Phase: Phase I and Phase II (Integrated)- First administration to humans. Countries: Spain (ongoing, recruiting), Germany (ongoing, recruiting).
Therapeutic area(s): Phenomena and Processes [G] - Genetic Phenomena [G05]
Gender: Female, Male. Age: 0-17 years. Enrolment: 15.
Status: Ongoing, recruiting. Start date (EU): 2024-03-04. Decision date: 2024-07-02. Results received: No. Last updated: 2026-04-30.
Decision dates by country: ES: 2024-07-02, DE: 2025-03-10

Condition(s): Congenital Hearing Loss Secondary to Biallelic Pathogenic Variants of the Otoferlin Gene (OTOF)
Product: DB-OTO

Primary endpoint: Incidence and severity of treatment-emergent adverse events, Achievement of a hearing sensitivity threshold of ≤70 dB assessed by average pure tone audiometry (PTA)
Endpoint(s): Auditory Brainstem Response (ABR) to click, Achievement of a hearing sensitivity threshold of ≤45 dB assessed by average PTA, Achievement of hearing sensitivity threshold of ≤25 dB assessed by average PTA, Speech perception scores by age-appropriate tests, Speech Awareness Threshold (SAT): achievement of a threshold of ≤70 dB, SAT: achievement of a threshold of ≤45 dB, SAT: achievement of threshold of ≤25 dB, Speech Reception Threshold (SRT): achievement of a threshold of ≤70 dB, SRT: achievement of a threshold of ≤45 dB, SRT: achievement of a threshold of ≤25 dB, Severity in speech perception ability assessed by Global Impression scales, determined by clinician, Severity in speech perception ability assessed by Global Impression scales, determined by parent/legal guardian, Change in speech perception ability assessed by Global Impression scales, determined by clinician, Change in speech perception ability assessed by Global Impression scales, determined by parent/legal guardian, Average PTA threshold in the subset of patients who achieved an average PTA threshold ≤70 dB, Average PTA threshold in the subset of patients who achieved an average PTA threshold >70 dB but ≤85 dB, Achievement of a hearing sensitivity threshold improvement of ≥10 dB from baseline, Time to an average PTA threshold ≤70 dB, Incidence of patients who regress to >70 dB after having achieved average PTA threshold ≤70 dB, Persistence of an average PTA threshold ≤70 dB

Source: https://euclinicaltrials.eu/ctis-public/view/2024-511342-40-00